EU clinical trial 2024-512022-28-01: A randomized, single-blind, placebo-controlled, study to examine the safety, tolerability, and pharmacokinetics of M6229 administered as a 120-hour continuous infusion at two dose levels versus placebo in healthy subjects
Protocol code: M6229-C002
Sponsor: Matisse Pharmaceuticals B.V. (Pharmaceutical company). Phase: Human Pharmacology (Phase I)- Other. Countries: Germany (ended).
Therapeutic area(s): Diseases [C] - Bacterial Infections and Mycoses [C01]
Gender: Female, Male. Age: 18-64 years. Enrolment: 15.
Status: Ended. Start date (EU): 2025-03-12. End date (EU): 2025-06-18. Decision date: 2024-10-16. Results received: No. Last updated: 2025-03-12.

Condition(s): Sepsis and Septic Shock

Source: https://euclinicaltrials.eu/ctis-public/view/2024-512022-28-01